EU clinical trial 2024-512720-11-00: A PIVOTAL, RANDOMIZED, PLACEBO-CONTROLLED, DOUBLE-BLIND, MULTICENTER, INTERNATIONAL PHASE III CLINICAL TRIAL TO INVESTIGATE THE EFFICACY AND SAFETY OF ALLO-APZ2-CVU ON WOUND HEALING OF THERAPY-RESISTANT NON-HEALING CHRONIC VENOUS ULCERS (CVU)
Protocol code: allo-APZ2-CVU-III
Sponsor: Rheacell GmbH & Co. KG (Pharmaceutical company). Phase: Therapeutic confirmatory (Phase III). Countries: Czechia (ongoing, recruitment ended), Austria (ongoing, recruitment ended), Sweden (ongoing, recruitment ended), Italy (ongoing, recruitment ended), Germany (ongoing, recruitment ended), Netherlands (ongoing, recruitment ended), Hungary (ongoing, recruitment ended), Slovakia (ongoing, recruitment ended), Poland (ongoing, recruitment ended), France (ongoing, recruitment ended).
Therapeutic area(s): Diseases [C] - Skin and Connective Tissue Diseases [C17]
Gender: Female, Male. Age: 18-64 years, 65+ years. Enrolment: 156.
Status: Ongoing, recruitment ended. Start date (EU): 2025-01-16. Decision date: 2024-12-16. Results received: No. Last updated: 2026-07-27.
Decision dates by country: HU: 2024-12-20, PL: 2024-12-20, CZ: 2025-01-08, NL: 2024-12-19, IT: 2024-12-20, SE: 2024-12-19, DE: 2024-12-17, SK: 2024-12-16, FR: 2024-12-26, AT: 2024-12-27

Condition(s): chronic venous ulcers (CVU)
Product: allo-APZ2-CVU, Placebo

Primary endpoint: Efficacy: Complete wound closure at Week 18 already persisting for at least two weeks, Safety: Adverse events
Endpoint(s): Complete wound closures at each post-baseline follow-up visit, Wound size change in percent at each post-baseline follow-up visit, Quality of wound healing at each post-baseline follow-up visit, Assessment of Quality of Life using the Wound-Quality of Life Questionnaire (W-QoL) as well as the EQ-5D-5L Questionnaire and the SF-36 at V8, V11, V14, V15, V16, V17, Pain assessment as per numerical rating scale (NRS) on each post-baseline follow-up visit, Duration of wound closure, Recurrence of the wound, Time to complete wound closure, Physical examination and vital signs at V14, Assessment of immunogenicity

Source: https://euclinicaltrials.eu/ctis-public/view/2024-512720-11-00